EU clinical trial 2024-511583-82-00: A phase III, multicentre, randomised, observer-blind, intraindividual, paired, comparative trial to evaluate the efficacy and safety of a 0.1% mometasone furoate cutaneous emulsion compared to Ecural® fat cream and vehicle cutaneous emulsion in the treatment of adult participants with plaque psoriasis
Protocol code: 410701BS
Sponsor: GALENpharma GmbH (Pharmaceutical company). Phase: Therapeutic confirmatory (Phase III). Countries: Poland (ended).
Therapeutic area(s): Diseases [C] - Skin and Connective Tissue Diseases [C17]
Gender: Female, Male. Age: 18-64 years, 65+ years. Enrolment: 99.
Status: Ended. Start date (EU): 2024-10-08. End date (EU): 2025-03-03. Decision date: 2024-08-12. Results received: Yes. Last updated: 2024-10-05.

Condition(s): Plaque psoriasis
Product: MomeGalen 1 mg/g cutaneous emulsion, Placebo to 0.1% mometasone furoate cutaneous emulsion (active ingredient-free vehicle of mometasone cutaneous emulsion), ECURAL Fettcreme, 1 mg/g Creme

Primary endpoint: Primary efficacy endpoint: % change from baseline in TSS on Day 22. Change from baseline in percent (%) is calculated as: % change=100*((TSS 22 - TSS 1) / TSS 1)
Endpoint(s): Secondary efficacy endpoints: % change from baseline in TSS on Day 8., Secondary efficacy endpoints: Changes from baseline in TSS on Days 8 and 22.

Source: https://euclinicaltrials.eu/ctis-public/view/2024-511583-82-00